EU clinical trial 2025-520721-21-00: A Phase 2, Multicenter, Platform Study of Targeted Therapies for the Treatment of Adult Subjects with Moderately to Severely Active Rheumatoid Arthritis.
Protocol code: M25-056
Sponsor: AbbVie Deutschland GmbH & Co. KG (Pharmaceutical company). Phase: Therapeutic exploratory (Phase II). Countries: Germany (ongoing, recruiting), Czechia (ongoing, recruitment ended), Hungary (ongoing, recruitment ended), Spain (ongoing, recruitment ended), Poland (ongoing, recruitment ended), Slovakia (ongoing, recruitment ended).
Therapeutic area(s): Diseases [C] - Immune System Diseases [C20]
Gender: Female, Male. Age: 18-64 years, 65+ years. Enrolment: 108.
Start date (EU): 2025-10-20. Decision date: 2025-09-12. Results received: No. Last updated: 2026-08-05.
Decision dates by country: SK: 2026-01-12, DE: 2025-09-12, CZ: 2026-01-13, HU: 2025-12-16, ES: 2026-01-19, PL: 2026-01-19

Condition(s): Rheumatoid Arthritis
Product: Lutikizumab, USP/Ph. Eur.ABBV-323, Universal Placebo (Lutikizumab, Ravagalimab)

Primary endpoint: Percentage of Participants With an American College of Rheumatology 50% (ACR50) Response at Week 12
Endpoint(s): Percentage of Participants With an American College of Rheumatology 20% (ACR20) Response at Week 12, Percentage of Participants With an American College of Rheumatology 70% (ACR70) Response at Week 12, Percentage Of Participants Achieving Low Disease Activity (LDA) per Disease Activity Score-28 With C-Reactive Protein (DAS28-CRP) at Week 12, Percentage Of Participants Achieving Clinical Remission (CR) per DAS28 (CRP) at Week 12, Change from Baseline in DAS28 (CRP) at Week 12, Percentage Of Participants Achieving LDA per Clinical Disease Activity Index (CDAI) at Week 12, Percentage Of Participants Achieving CR per CDAI at Week 12

Source: https://euclinicaltrials.eu/ctis-public/view/2025-520721-21-00